EU clinical trial 2023-503911-14-00: A Phase 2, International, Multicenter, Randomized, Double-blind, Placebo-controlled, Dose-ranging study of Efficacy and Safety of SAR441566 in Adults with Moderate to Severe Plaque Psoriasis
Protocol code: DRI17849
Sponsor: Sanofi-Aventis Recherche & Developpement (Pharmaceutical company). Phase: Therapeutic exploratory (Phase II). Countries: Spain (ended), Germany (ended), Hungary (ended), Portugal (ended), Czechia (ended), Poland (ended), Bulgaria (ended).
Therapeutic area(s): Diseases [C] - Immune System Diseases [C20]
Gender: Female, Male. Age: 18-64 years, 65+ years. Enrolment: 242.
Status: Ended. Start date (EU): 2024-01-25. End date (EU): 2024-11-20. End date: 2024-12-11. Decision date: 2023-12-15. Results received: Yes. Last updated: 2024-12-09.
Decision dates by country: BG: 2024-01-04, CZ: 2024-01-11, PT: 2023-12-20, HU: 2023-12-18, PL: 2023-12-21, DE: 2023-12-18, ES: 2023-12-15

Condition(s): Psoriasis
Product: Match Placebo to Test Product, SAR441566, SAR441566

Primary endpoint: Proportion of participants with a 75% or greater PASI score (Psoriasis Area and Severity Index score) improvement (reduction) from baseline (PASI75) at week 12
Endpoint(s): PASI percent change from baseline to week 12, Proportion of participants with static Psoriasis Global Assessment (sPGA) score 0 (complete clearance) or 1 (minimal disease) at week 12, Number of participants with Treatment- Emergent Adverse Events (TEAEs), serious AEs (SAEs), and AEs of special interest (AESIs), Plasma pre-dose concentrations of SAR441566, Plasma post-dose concentrations of SAR441566

Source: https://euclinicaltrials.eu/ctis-public/view/2023-503911-14-00